EU clinical trial 2023-509703-33-00: Empirical Meropenem versus Piperacillin/Tazobactam for Adult Patients with Sepsis (EMPRESS) trial
Sponsor: Rigshospitalet (Hospital/Clinic/Other health care facility). Phase: Therapeutic use (Phase IV). Countries: Denmark (ongoing, recruiting), Sweden (authorised, recruitment pending).
Therapeutic area(s): Diseases [C] - Bacterial Infections and Mycoses [C01]
Gender: Female, Male. Age: 18-64 years, 65+ years. Enrolment: 700.
Start date (EU): 2025-06-26. Decision date: 2024-04-10. Results received: No. Last updated: 2026-06-10.
Decision dates by country: SE: 2026-01-29, DK: 2024-04-10

Condition(s): Septic Shock, Sepsis
Product: MEROPENEM, PIPERACILLIN AND BETA-LACTAMASE INHIBITOR

Primary endpoint: All-cause mortality at day 30 after randomisation
Endpoint(s): Number of participants with one or more serious adverse reactions (SARs, defined as anaphylactic shock to IV piperacillin/tazobactam or meropenem, invasive fungal infection, pseudomembranous colitis, or toxic epidermal necrolysis) within 30 days of randomisation, Number of participants with new isolation precautions due to one or more resistant bacteria within 30 days of randomisation, Days alive without life support (i.e., invasive mechanical ventilation, circulatory support, or renal replacement therapy [including days in between intermittent renal replacement therapy]) from randomisation to day 30, Days alive and out of hospital from randomisation to day 30, Days alive without life support (i.e., invasive mechanical ventilation, circulatory support, or renal replacement therapy [including days in between intermittent renal replacement therapy]) from randomisation to day 90, Days alive and out of hospital from randomisation to day 90, All-cause mortality at day 90, All-cause mortality at day 180, HRQoL at day 180 using EQ-5D-5L index values, HRQoL at day 180 using EQ VAS

Source: https://euclinicaltrials.eu/ctis-public/view/2023-509703-33-00